EU clinical trial 2024-514349-13-00: A2B-trial Antibioprophylaxis for excision-graft surgery in burn patient : a multicenter randomized double-bling study
Protocol code: APHP180605
Sponsor: Assistance Publique Hopitaux De Paris (Hospital/Clinic/Other health care facility). Phase: Therapeutic confirmatory (Phase III). Countries: France (ongoing, recruiting).
Therapeutic area(s): Diseases [C] - Bacterial Infections and Mycoses [C01]; Analytical,Diagnostic,Therapeutic Techniques and Equipment [E]-Surgical Procedures, Operative [E04]
Gender: Female, Male. Age: 18-64 years, 65+ years. Enrolment: 506.
Status: Ongoing, recruiting. Start date (EU): 2020-10-11. Decision date: 2024-08-23. Results received: No. Last updated: 2026-04-02.

Condition(s): Excision-autograft surgery in burn patient
Product: PIPERACILLINE TAZOBACTAM VIATRIS 4 g/0,5 g, poudre pour solution pour perfusion, CEFAZOLIN, Placebo de Cefazoline / Piperaciline / Tazobactam

Primary endpoint: Post-operative infection defined as Post-operative sepsis and/or surgical site infection, and/or autograft lysis requiring a new autograft within 7 days after surgery
Endpoint(s): - 90 days mortality, - Skin raft lysis requiring a new autograft procedure, - Post-operative pulmonary infection, - Number of days of hospitalization until complete healing (> 95% total burn surface area), - Number of hospitalization days living without antibiotic therapy at D28 and D90, - Multiresistant bacteria (15) colonization of infection at D28 and D90

Source: https://euclinicaltrials.eu/ctis-public/view/2024-514349-13-00